EU clinical trial 2025-522509-39-00: Pacritinib For The Reduction Of Bone Marrow Fibrosis In Patients With Myelofibrosis Who Have Thrombocytopenia; A Multicenter, Open-Label, Single Arm, Phase II Exploratory Study
Protocol code: GEMFIN-MF-PACRI 2401
Sponsor: Grupo Espanol De Enfermedades Mieloproliferativas Cronicas Ph (Patient organisation/association). Phase: Therapeutic exploratory (Phase II). Countries: Spain (ongoing, recruiting).
Therapeutic area(s): Diseases [C] - Neoplasms [C04]
Gender: Female, Male. Age: 18-64 years, 65+ years. Enrolment: 30.
Status: Ongoing, recruiting. Start date (EU): 2026-03-30. Decision date: 2026-02-06. Results received: No. Last updated: 2026-06-30.

Condition(s): Patients with myelofibrosis and platelets counts between 50 - 120 x 10e9/L
Product: Pacritinib

Primary endpoint: Decrease of ≥1 grade in reticulin fibrosis from baseline to week 52 measured in bone marrow biopsy.
Endpoint(s): Improvement in bone marrow fat fraction (FF) at Week 52 (C12D1) from baseline, measured by quantitative MRI as has been previously described, Percent change in fat fraction by quantitative Dixon Quant MRI will be correlated with improvement in BM fibrosis by at least 1 grade (assessment by BM biopsy) at Week 52., To evaluate anemia response a) Achievement of RBC transfusion independence over the first 24 weeks of treatment. b) Improvement in hemoglobin level without transfusion over the first 24 weeks of treatment c) Correlation study between i) the changes in hemoglobin level without transfusion and/or proportion of patients achievement of RBC transfusion independence with ii) the changes in the Bone Marrow (by MRI and/or BM biopsy) over the first 24 weeks of treatment., Durability of anemia response a) Achievement of RBC transfusion independence over the first 52 weeks of treatment. b) Improvement in hemoglobin level without transfusion over the first 52 weeks of treatment c) Correlation study between i) the changes in hemoglobin level without transfusion and/or proportion of patients achievement of RBC transfusion independence with ii) the changes in in the Bone Marrow (by MRI and/or BM biopsy) over the first 52 weeks, Improvement in platelet counts without transfusion at week 24 from baseline, Improvement in platelet counts without transfusion at week 52 from baseline, Post-treatment changes in MPN driver-gen VAF (JAK2, CALR, MPL) from baseline at Week 24 and Week 52., Percent change in fat fraction by quantitative Dixon Quant MRI and/or in the grade of fibrosis in BM will be correlated with the percent change in splenic volume; with the percent change in the driver-gen VAF; and with the hemoglobin and platelet levels at Week 24 and Week 52., Post-treatment changes in MPN driver-gen VAF will be correlated with the percent change in splenic volume; and with the hemoglobin and platelet levels at Week 24 and Week 52, Frequency and severity of adverse events and Treatment-related adverse events (TRAEs) assessed by NCI CTCAE v5.0, Rate of completion of pacritinib treatment: Cumulative dose Actual dose intensity Relative dose intensity Proportion of patients requiring dose interruptions Proportion of patients requiring dose reductions, Assessement of MF or dual IRAK-1/JAK2 inhibitor (pacritinib) biology-related features associated with response: ● Changes in the levels of circulating plasma cytokines at week 24 from baseline by Luminex ● Changes in the mRNA and/or protein expression levels of of TGT betha and NFkB targets will be measures at week 24 in bone marrow and compare between responders and non-responders to pacritinib., Decrease of ≥1 grade in reticulin fibrosis from baseline to week 24 measured in bone marrow biopsy., Improvement in bone marrow fat fraction (FF) at Week 24 from baseline, measured by quantitative MRI, Percent change in fat fraction by quantitative Dixon Quant MRI and improvement in BM histology (assessment by BM biopsy) at Week 24., Changes in MPN symptoms throughout the study period assessed through MPN SAF TSS 2.0 questionnaire, Percent change in splenic volume at Week 24 and Week 52 among patients with baseline splenomegaly

Source: https://euclinicaltrials.eu/ctis-public/view/2025-522509-39-00